EU clinical trial 2024-516896-34-00: Phase I/II combination umbrella trial in progressive/relapsed/refractory pediatric low-grade glioma (pLGG) (EPILOGUE)
Protocol code: KiTZ-EPILOGUE-2024
Sponsor: Universitaetsklinikum Heidelberg AöR (Hospital/Clinic/Other health care facility). Phase: Phase I and Phase II (Integrated)- Other. Countries: Denmark (authorised, recruitment pending), Czechia (authorised, recruiting), Austria (authorised, recruitment pending), Sweden (authorised, recruitment pending), Germany (authorised, recruiting).
Therapeutic area(s): Diseases [C] - Nervous System Diseases [C10]; Diseases [C] - Neoplasms [C04]
Gender: Female, Male. Age: 0-17 years, 18-64 years. Enrolment: 34.
Start date (EU): 2026-06-17. Decision date: 2026-03-17. Results received: No. Last updated: 2026-06-09.
Decision dates by country: AT: 2026-03-22, CZ: 2026-03-17, DK: 2026-03-23, DE: 2026-03-18, SE: 2026-03-17

Condition(s): progressive/relapsed/refractory pediatric low-grade glioma (pLGG)
Product: Vinblastinsulfat Teva® 1 mg/ml Injektionslösung, Tovorafenib

Primary endpoint: DLT of the combination treatment regimens, Best response (CR or PR) will be based on RAPNO-LGG criteria, defined for each patient as the best response under study treatment period (maximum 12 cycles) (assessment every 8 weeks) by central review.
Endpoint(s): Duration of Response (DOR) and Disease Control Rate (DCR), Adverse events according to Common Toxicity Criteria for Adverse Events (CTCAE) v5.0, PFS and OS, RR in the population that reaches MTD, Selection of promising arm(s) for further investigation by steering committee on the basis of the totality of data (activity, tolerability and functional outcome(s)), ORR2, DOR2, DCR2 and PFS2 after re-challenge for rebound tumor growth, MR based on RAPNO-LGG, TTR and time to best response, Comparison of best response between treatment arms, Ulixertinib and tovorafenib plasma PK

Source: https://euclinicaltrials.eu/ctis-public/view/2024-516896-34-00